EU clinical trial 2025-521758-40-00: Intravitreal (IVT) Pozelimab for Geographic Atrophy (GA) in Adult Participants
Protocol code: R3918-AMD-2501
Sponsor: Regeneron Pharmaceuticals Inc. (Pharmaceutical company). Phase: Human Pharmacology (Phase I)- First administration to humans. Countries: Romania (ongoing, recruiting).
Therapeutic area(s): Diseases [C] - Eye Diseases [C11]
Gender: Female, Male. Age: 18-64 years, 65+ years. Enrolment: 16.
Status: Ongoing, recruiting. Start date (EU): 2026-05-04. Decision date: 2026-03-23. Results received: No. Last updated: 2026-03-23.

Condition(s): Geographic Atrophy

Source: https://euclinicaltrials.eu/ctis-public/view/2025-521758-40-00